EU clinical trial 2024-519284-18-00: Evaluating safety, efficacy and pharmacokinetics of a modified regimen of ublituximab (ENHANCE)
Protocol code: TG1101-RMS401
Sponsor: Tg Therapeutics Inc. (Pharmaceutical company). Phase: Therapeutic confirmatory (Phase III). Countries: Poland (ongoing, recruiting).
Therapeutic area(s): Diseases [C] - Nervous System Diseases [C10]
Gender: Female, Male. Age: 18-64 years, 65+ years. Enrolment: 233.
Status: Ongoing, recruiting. Start date (EU): 2025-06-18. Decision date: 2025-03-20. Results received: No. Last updated: 2026-06-29.

Condition(s): Relapsing multiple sclerosis
Product: ublituximab placebo, CETIRIZINE, METHYLPREDNISOLONE, DEXAMETHASONE, DIPHENHYDRAMINE, PARACETAMOL, GADOBUTROL, ublituximab

Primary endpoint: Part A: The proportion of participants with no change or reduction in number of T1 Gd-enhancing lesions from baseline to Week 48, Part B: PK (AUC) over the first 16 weeks (AUC0-W16), Part C: Proportion of participants with no change or reduction in number of T1 Gd-enhancing lesions
Endpoint(s): Part A: The proportion of participants free of T1 Gd-enhancing lesions at Week 48, Part A: The proportion of participants experiencing IRRs as reported by the Investigator, Part A: Treatment Satisfaction Questionnaire for Medication (TSQM-9) scores at Week 24 and Week 48, Part A: Pharmacokinetics of ublituximab, Part B: The proportion of participants who experience any grade treatment-emergent adverse events (TEAEs), Part B: The proportion of participants experiencing IRR as reported by the Investigator, Part B: The number of T1 Gd-enhancing lesions per MRI scan at Week 24 and Week 48, Part B: PK (Cmax) at Day 1 and Day 15, Part B: The proportion of participants with CD19+ B-cell counts below a specific level at all timepoints, Part C: Proportion of participants free of T1 Gd-enhancing lesions, Part C: The proportion of participants experiencing IRRs as reported by the Investigator, Part C: Treatment Satisfaction Questionnaire for Medication (TSQM-9) scores at each timepoint, Part C: Change from baseline in PROMIS-Fatigue-MS-8a at each timepoint, Part C: Neuro-QOL at each timepoint

Source: https://euclinicaltrials.eu/ctis-public/view/2024-519284-18-00